EU clinical trial 2024-520218-23-00: An Adaptive, 2-Part, Randomized, Double-Blind, Placebo-Controlled Trial to Evaluate the Efficacy and Safety of IKT-001 in Pulmonary Arterial Hypertension.
Protocol code: IKT-001-201
Sponsor: Inhibikase Therapeutics Inc. (Pharmaceutical company). Phase: Phase II and Phase III (Integrated). Countries: Spain (authorised, recruitment pending), Poland (authorised, recruitment pending), Italy (authorised, recruitment pending), Belgium (authorised, recruitment pending), Latvia (authorised, recruitment pending), Denmark (authorised, recruitment pending), Czechia (authorised, recruitment pending), Germany (authorised, recruitment pending), France (authorised, recruitment pending), Netherlands (authorised, recruitment pending), Portugal (authorised, recruitment pending), Ireland (authorised, recruitment pending), Austria (authorised, recruitment pending), Greece (authorised, recruitment pending), Lithuania (authorised, recruitment pending).
Therapeutic area(s): Diseases [C] - Cardiovascular Diseases [C14]
Gender: Female, Male. Age: 18-64 years, 65+ years. Enrolment: 112.
Status: Authorised, recruitment pending. Decision date: 2026-04-28. Results received: No. Last updated: 2026-07-27.
Decision dates by country: BE: 2026-04-29, FR: 2026-04-29, DE: 2026-04-30, IT: 2026-04-30, ES: 2026-04-30, NL: 2026-04-28, IE: 2026-05-01, LV: 2026-04-29, PT: 2026-04-30, AT: 2026-07-27, GR: 2026-05-28, LT: 2026-07-07, DK: 2026-05-11, PL: 2026-04-30, CZ: 2026-04-29

Condition(s): Pulmonary Arterial Hypertension
Product: IkT-001Pro, Placebo to match 100 mg IKT-001 tablets

Primary endpoint: 1. Part A: Change from baseline in PVR at Week 24, 2. Part B: Change from baseline in 6MWD at Week 24
Endpoint(s): 1. Part A only: Change from baseline in 6MWD at Week 24, 2. Part B only: Change from baseline in PVR at Week 24, 3. Change from baseline in NT-proBNP concentrations at Week 24, 4. Time to all-cause death or the first occurrence of a clinical worsening event (time to clinical worsening), 5. Proportion of participants who improve from baseline in WHO FC or maintain WHO FC II from baseline to Week 24, 6. Proportion of participants who maintain low or intermediate-low risk score or achieve a lower ESC/ERS 4 strata risk score at Week 24, 7. Change from baseline in HRQoL / EmPHasis-10 total score at Week 24

Source: https://euclinicaltrials.eu/ctis-public/view/2024-520218-23-00